EU clinical trial 2024-514476-40-00: Randomized, placebo-controlled, double-blind study to evaluate the efficacy of 2LVERU®JUNIOR and 2LVERU® on the treatment of warts.
Sponsor: Labo'Life Belgium (Pharmaceutical company). Phase: Phase III and phase IV (Integrated). Countries: Belgium (ongoing, recruiting).
Therapeutic area(s): Diseases [C] - Virus Diseases [C02]
Gender: Female, Male. Age: 0-17 years, 18-64 years. Enrolment: 162.
Status: Ongoing, recruiting. Start date (EU): 2024-06-03. Decision date: 2024-05-31. Results received: No. Last updated: 2024-05-31.

Condition(s): Non genital warts infection
Product: 2LVERU JUNIOR granules en gélules à ouvrir, Placebo, 2LVERU granules en gélules à ouvrir

Primary endpoint: Disappearance of warts at the end of treatment (6-month visit)
Endpoint(s): - Disappearance of warts at 4 months. - Disappearance level (total disappearance, partial disappearance (50%), no modification, increase of number of warts) at 4 months and 6 months, - Warts recurrence at 3-month visit post-treatment - Pain evaluation during the study by VAS and consumption of antalgic medication. - Safety: occurrence of adverse events (AEs) and severe adverse events (SAEs), considered as related or not to the study drug.

Source: https://euclinicaltrials.eu/ctis-public/view/2024-514476-40-00